EU clinical trial 2023-509383-15-00: An intensive program with quadruplet induction and consolidation plus tandem autologous stem cell transplantation in Newly Diagnosed High Risk Multiple Myeloma Patients: a phase II study of the Intergroupe Francophone du Myélome (IFM 2018-04)
Sponsor: Centre Hospitalier Universitaire De Nantes (Hospital/Clinic/Other health care facility). Phase: Therapeutic exploratory (Phase II). Countries: France (ongoing, recruitment ended).
Therapeutic area(s): Diseases [C] - Hemic and Lymphatic Diseases [C15]
Gender: Female, Male. Age: 18-64 years, 65+ years. Enrolment: 50.
Status: Ongoing, recruitment ended. Start date (EU): 2024-07-05. Decision date: 2024-07-05. Results received: No. Last updated: 2026-07-08.

Condition(s): Multiple Myeloma

Source: https://euclinicaltrials.eu/ctis-public/view/2023-509383-15-00